EU clinical trial 2023-508563-73-00: A Randomised, Observer-Blind Trial to Evaluate the Immunogenicity, Safety, and Reactogenicity of a Group B Streptococcus Vaccine (GBS-NN/NN-2) when 1 Dose is Administered Concomitantly with the TDaP Vaccine in Healthy Non-pregnant Women 18 to 49 years of age Compared to when Each Vaccine is Administered Alone
Protocol code: MVX009
Sponsor: Minervax ApS (Pharmaceutical company). Phase: Phase II and Phase III (Integrated). Countries: Belgium (authorised, recruitment pending), Poland (authorised, recruitment pending).
Therapeutic area(s): Diseases [C] - Bacterial Infections and Mycoses [C01]
Gender: Female. Age: 18-64 years. Enrolment: 564.
Status: Authorised, recruitment pending. Decision date: 2024-10-30. Results received: No. Last updated: 2024-10-31.
Decision dates by country: BE: 2024-10-30, PL: 2024-10-31

Condition(s): Prevention of Group B streptococcus infection
Product: Boostrix Injektionssuspension in einer Fertigspritze Diphtherie-, Tetanus- und Pertussis (azellulär, aus Komponenten)-Adsorbatimpfstoff (mit reduziertem Antigengehalt), 0.9% sodium chloride

Primary endpoint: At 28 days after the third vaccination: o Anti-tetanus toxoid antibody concentration ≥0.1 IU/mL o Anti-diphtheria toxoid antibody concentrations ≥0.1 IU/mL, At 28 days after the third vaccination: o Anti-pertussis toxin antibodies o Anti-FHA antibodies o Anti-PRN antibodies, At 28 days after the third vaccination for Groups 1 and 2; and 28 days after the second vaccination for Groups 3 and 4: o Antibody concentrations for RibN, Alp1N, Alp2N, and AlpCN, Solicited local AEs within 7 days after each dose (ie, the day of dosing + 6 days post-dose), Solicited systemic AEs within 7 days after each dose (ie, the day of dosing + 6 days post-dose), Unsolicited AEs within 28 days after each dose (ie, the day of dosing + 27 days post-dose), SAEs from the first dose to the end of the trial
Endpoint(s): MAAEs from the first dose to the end of the trial

Source: https://euclinicaltrials.eu/ctis-public/view/2023-508563-73-00